EU clinical trial 2023-509776-41-00: Phase I Clinical Study to Assess Safety and Efficacy of Repotrectinib Combined with Osimertinib in Patients with Advanced, Metastatic EGFR Mutant NSCLC (TOTEM).
Protocol code: IOR-BMS-IST-002
Sponsor: Instituto Oncologico Dr. Rosell S.L. (Hospital/Clinic/Other health care facility). Phase: Human Pharmacology (Phase I)- Other. Countries: Spain (ended).
Therapeutic area(s): Diseases [C] - Neoplasms [C04]
Gender: Female, Male. Age: 18-64 years, 65+ years. Enrolment: 48.
Status: Ended. Start date (EU): 2021-06-30. End date (EU): 2026-05-04. Decision date: 2024-07-23. Results received: No. Last updated: 2024-07-23.

Condition(s): Non-small cell lung cancer (NSCLC)

Source: https://euclinicaltrials.eu/ctis-public/view/2023-509776-41-00